EU clinical trial 2023-510117-26-00: A Phase 2 Study of Tremelimumab (Day 1 only), Durvalumab (MEDI4736) and Trans-arterial catheter chemoembolization (TACE)in patients with advanced Hepatocellular Carcinoma (HCC)
Protocol code: UCDCRC/23/06
Sponsor: University College Dublin (Educational Institution). Phase: Therapeutic exploratory (Phase II). Countries: Ireland (ended).
Therapeutic area(s): Diseases [C] - Neoplasms [C04]
Gender: Female, Male. Age: 18-64 years, 65+ years. Enrolment: 29.
Status: Ended. End date (EU): 2025-05-06. Decision date: 2024-05-31. Results received: Yes. Last updated: 2025-03-31.

Condition(s): Advanced Hepatocellular Carcinoma (HCC)
Product: IMJUDO 20 mg/ml concentrate for solution for infusion., Doxorubicin Teva 2 mg/ml Concentrate for Solution for Infusion, Niopam 300, solution for injection, glass bottles, Omnipaque 240 mg I/ml Solution for Injection., IMFINZI 50 mg/mL concentrate for solution for infusion., Omnipaque 300 mg I/ml Solution for Injection.

Primary endpoint: 6-month Progression-free survival (PFS) with median PFS included in statistical analysis
Endpoint(s): Safety, Overall survival time, Best overall response rate, EXPLORATORY ENDPOINT: Changes in immune parameters in the peripheral blood over time

Source: https://euclinicaltrials.eu/ctis-public/view/2023-510117-26-00